EU clinical trial 2023-506546-23-00: Teicoplanin as Infection Prophylaxis in Pediatric Acute Myeloid Leukemia (Pro-Teico study) An open-label, randomized clinical trial on teicoplanin infection prophylaxis in pediatric patients with acute myeloid leukemia
Protocol code: SP_MH19PRO
Sponsor: Prinses Maxima Centrum voor Kinderoncologie B.V. (Hospital/Clinic/Other health care facility). Phase: Therapeutic confirmatory (Phase III). Countries: Netherlands (ongoing, recruiting), Belgium (ongoing, recruiting), Spain (ongoing, recruiting), Denmark (ongoing, recruiting).
Therapeutic area(s): Diseases [C] - Neoplasms [C04]
Gender: Female, Male. Age: 0-17 years, 18-64 years. Enrolment: 128.
Status: Ongoing, recruiting. Start date (EU): 2020-05-20. Decision date: 2024-07-17. Results received: No. Last updated: 2025-11-20.
Decision dates by country: NL: 2024-07-17, DK: 2024-07-25, ES: 2024-07-18, BE: 2024-07-22

Condition(s): Acute myeloid leukemia
Product: Targocid 400mg powder for solution for injection/infusion or oral solution, Targocid 400mg powder for solution for injection/infusion or oral solution, Targocid 400mg powder for solution for injection/infusion or oral solution, Targocid 400mg powder for solution for injection/infusion or oral solution

Primary endpoint: For safety run in phase: The number of DLTs observed, For the randomized controlled phase: The (first) occurrence of a culture-proven BSI with VGS during initial AML treatment, For the randomized controlled phase: Date(s) of BSI(s) with VGS.
Endpoint(s): Safety run in phase: PK parameters of teicoplanin, e.g., o Css,max o Css,min o Tss,max o Area under the curve o Clearance (inter-compartmental, total, renal fraction) o Volume of distribution (central and peripheral), The number of BSIs with culture-proven bacteria; o Results of all positive blood cultures, Infection-related (pediatric) intensive care admissions; o Days at the intensive care, The number of episodes/admissions with (neutropenic) fever; o Days with fever (with or without neutropenia) o Days with FN o Days with neutropenia, Infection-free survival time, i.e., time from diagnosis to the first culture-proven BSI, Infection-related mortality, Number of days until neutrophil recovery (ANC of ≥0.5 x109/L following the nadir), Resistance patterns of pathogenic isolates from blood cultures, Incidence of resistant bacteria in rectal swabs: o VRE, Incidence of resistant bacteria in (routine) surveillance cultures; throat and rectal swabs, e.g.,; o Gram-negative staphylococci o Hemolytic streptococci o Staphylococcus aureus o Fungi o Yeasts o Haemophilus influenza (only throat swab) o Pneumococci (only throat swab), AEs of special interest, i.e.; o Grade 3 or 4 increases in serum creatinine o Grade 3 or 4 hearing impairment o Grade 3 or 4 allergic or infusion-related reaction to teicoplanin administration o Grade 3 or 4 anaphylactic reaction to teicoplanin administration o Grade 3 or 4 sepsis with teicoplanin-resistant organisms o The occurrence of teicoplanin-resistant organisms in routine surveillance cultures, Serious adverse events (SAEs), Use of (other) antibiotics, antifungals and antivirals, PK parameters of teicoplanin, e.g.,; o Css,max o Css,min o Tss,max o Area under the curve o Clearance (inter-compartmental, total, renal fraction) o Volume of distribution (central and peripheral), Serum creatinine levels, Serum levels of teicoplanin, Duration of response (time between achieving complete remission (CR) after starting study treatment and documented relapse or death);, CIR (Cumulative incidence of relapse), EFS (Event-free survival), OS (Overall survival)

Source: https://euclinicaltrials.eu/ctis-public/view/2023-506546-23-00